EU clinical trial 2025-522647-17-00: A two-part study: open label, dose escalation phase aimed to evaluate the safety and tolerability of two different doses of allogeneic fibroblasts for the treatment of chronic refractory wounds and identifying the best dose for subsequent cohort expansion phase aimed to assess efficacy and confirm safety and tolerability
Protocol code: FB Plus-01-23
Sponsor: Hmg Biologics S.r.l. (Pharmaceutical company). Phase: Phase I and Phase II (Integrated)- First administration to humans. Countries: Italy (authorised, recruitment pending).
Therapeutic area(s): Diseases [C] - Skin and Connective Tissue Diseases [C17]
Gender: Female, Male. Age: 18-64 years, 65+ years. Enrolment: 52.
Status: Authorised, recruitment pending. Decision date: 2026-04-15. Results received: No. Last updated: 2026-04-15.

Condition(s): Refractory wounds
Product: FB-Plus, FB-Plus

Primary endpoint: Safety endpoints: Incidence, type, intensity (severity), seriousness and treatment causality of Treatment Emergent Adverse Events (TEAEs, i.e. AEs that occur after the product application)., Safety endpoints: Changes from baseline in physical examination, vital signs, 12-lead ECG, blood and urine analyses., Safety endpoints: Overall tolerability assessment by the Investigator measured through a 5-points Likert Scale (1=very well tolerated, 2=well tolerated, 3=neither well nor badly tolerated, 4=not tolerated, 5=not tolerated at all)., Efficacy endpoints: Ulcer dimension change from baseline (scored in six categories: 0=unchanged, 1=reduction ≤30%, 2=reduction between 30 and 50%, 3=reduction between 50 and 70%, 4=reduction between 70 and 100%, 5=healed)., Efficacy endpoints: Change in the ulcer dimension (cm2)., Efficacy endpoints: Changes in the Wound Bed Score (WBS)., Efficacy endpoints: Changes in the wound pain intensity, as reported by the patient through a Visual Analogue Scale (VAS)., Efficacy endpoints: Overall satisfaction assessment by the Investigator on the study product efficacy through a 5-points Likert Scale (1=very satisfied, 2=satisfied, 3=not satisfied nor unsatisfied, 4=not satisfied, 5=not satisfied at all)., Efficacy endpoint: Number of responders (responder = with ulcer area reduction ≥50%)., Efficacy endpoint: The time to 50% wound reduction., Efficacy endpoint: Time to healing (if occurring)., Efficacy endpoint: Changes in Wound-QoL-14 questionnaire score.

Source: https://euclinicaltrials.eu/ctis-public/view/2025-522647-17-00